EU clinical trial 2023-503647-34-00: A randomized, open-label, reference-replicated crossover trial to investigate the bioequivalence of two formulations of Silexan 80 mg in healthy volunteers
Protocol code: D.01.01.2.03
Sponsor: Dr. Willmar Schwabe GmbH & Co. KG (Pharmaceutical company). Phase: Human Pharmacology (Phase I)- Bioequivalence Study. Countries: France (ended).
Therapeutic area(s): Not possible to specify
Gender: Female, Male. Age: 18-64 years. Enrolment: 92.
Status: Ended. Start date (EU): 2023-08-31. End date (EU): 2024-01-24. Decision date: 2023-08-02. Results received: Yes. Last updated: 2023-11-09.

Condition(s): Healthy volunteers
Product: HUILE ESSENTIELLE DE LAVANDE SCHWABE capsule molle, Silexan 80 mg

Primary endpoint: Area under the curve (AUC) from time zero (time of investigational medicinal product [IMP] administration) to the time of last measured concentration (AUC0-last), AUC from time zero (time of IMP administration) to infinity with extrapolation of the terminal phase (AUC0-inf) and maximum observed plasma concentration (Cmax) of Linalool
Endpoint(s): Concentration at time (t) (Ct), extrapolation of AUC0-inf (AUCext), time to reach Cmax (tmax), terminal half-life (t1/2), time prior to the first measurable non-zero concentration (tlag) and terminal elimination rate constant (λz) of Linalool, Incidence, nature and severity of AEs and ADRs, AEs and ADRs leading to IMP/trial discontinuation, Serious AEs (SAEs) and serious ADRs (SADRs), Changes in vital signs and physical examination

Source: https://euclinicaltrials.eu/ctis-public/view/2023-503647-34-00